EU clinical trial 2024-515563-55-00: An open single-center, phase I proof of concept trial to assess the safety and feasibility of adoptive cell therapy with autologous EBV-specific cytotoxic T lymphocytes (CTL) in patients with a first clinical episode highly suggestive of multiple sclerosis
Protocol code: RC14_0359
Sponsor: Centre Hospitalier Universitaire De Nantes (Hospital/Clinic/Other health care facility). Phase: Human Pharmacology (Phase I)- Other. Countries: France (ongoing, recruiting).
Therapeutic area(s): Diseases [C] - Nervous System Diseases [C10]
Gender: Female, Male. Age: 18-64 years. Enrolment: 7.
Status: Ongoing, recruiting. Start date (EU): 2025-02-17. Decision date: 2024-10-03. Results received: No. Last updated: 2025-02-12.

Condition(s): Multiple sclerosis

Source: https://euclinicaltrials.eu/ctis-public/view/2024-515563-55-00